EU clinical trial 2024-512119-34-00: C4221022 - A PHASE 2, RANDOMIZED, OPEN-LABEL STUDY OF ENCORAFENIB AND CETUXIMAB PLUS PEMBROLIZUMAB VERSUS PEMBROLIZUMAB ALONE IN PARTICIPANTS WITH PREVIOUSLY UNTREATED BRAF V600E-MUTANT, MSI-H/DMMR METASTATIC COLORECTAL CANCER
Protocol code: C4221022
Sponsor: Pfizer Inc. (Pharmaceutical company). Phase: Therapeutic exploratory (Phase II). Countries: Czechia (ongoing, recruitment ended), Germany (ongoing, recruitment ended), France (ongoing, recruitment ended), Denmark (ongoing, recruitment ended), Sweden (ended), Poland (ongoing, recruitment ended), Belgium (ongoing, recruitment ended), Norway (ongoing, recruitment ended), Netherlands (ongoing, recruitment ended), Spain (ongoing, recruitment ended), Slovakia (ongoing, recruitment ended), Italy (ongoing, recruitment ended).
Therapeutic area(s): Diseases [C] - Neoplasms [C04]
Gender: Female, Male. Age: 0-17 years, 18-64 years, 65+ years. Enrolment: 75.
Start date (EU): 2022-06-20. Decision date: 2024-07-18. Results received: No. Last updated: 2026-06-30.
Decision dates by country: SE: 2024-07-18, NO: 2024-07-18, NL: 2024-07-18, BE: 2024-07-18, PL: 2024-07-18, DK: 2024-07-21, FR: 2024-07-18, IT: 2024-07-23, ES: 2024-07-22, SK: 2024-07-18, CZ: 2024-07-23, DE: 2024-07-22

Condition(s): MSI-H/dMMR metastatic colorectal cancer
Product: ENCORAFENIB, CETUXIMAB, PEMBROLIZUMAB, PEMBROLIZUMAB

Primary endpoint: PFS per investigator, defined as the time from randomization until PD based on investigator assessment per RECIST v1.1 or death due to any cause, whichever occurs first
Endpoint(s): Incidence and severity of AEs graded according to the NCI CTCAE v4.03 and changes in clinical laboratory test parameters, vital signs and ECGs, - Incidence of dosing interruptions, dose modifications and permanent discontinuations associated with AEs, - OS, defined as the time from the date of randomization to the date of death due to any cause, - Objective response, defined as confirmed CR or confirmed PR based on investigator assessment per RECIST v1.1, from the date of randomization until the date of the first documentation of PD, death or start of new anticancer therapy, - DOR, defined as the time from the first response, until PD based on investigator assessment per RECIST v1.1 or death due to any cause, whichever occurs first, BRAF and MSI-status as determined by retrospective central testing of baseline tumor tissue;, EORTC QLQ-C30: change from baseline in the global health status/QoL, functional and symptom scales, and single items, - EQ-5D-5L: change from baseline in the index score and VAS, - PGIS score: change from baseline in the score, - PGIC score

Source: https://euclinicaltrials.eu/ctis-public/view/2024-512119-34-00